EU clinical trial 2024-519740-32-00: Tolerance of local administration of cryopreserved autologous stromal vascular fraction combined with micrograft for the treatment of refractory ano-perineal fistulas in Crohn's disease
Protocol code: ADICROHN III
Sponsor: Centre Hospitalier Regional De Marseille (Hospital/Clinic/Other health care facility). Phase: Therapeutic exploratory (Phase II). Countries: France (ongoing, recruiting).
Therapeutic area(s): Diseases [C] - Digestive System Diseases [C06]
Gender: Female, Male. Age: 18-64 years, 65+ years. Enrolment: 25.
Status: Ongoing, recruiting. Start date (EU): 2025-12-29. Decision date: 2025-06-02. Results received: No. Last updated: 2025-06-02.

Condition(s): Crohn's disease
Product: thawed SVF 2 susp prep

Primary endpoint: Absence of local infectious complications, defined by the absence of local inflammatory signs: pain, and/or erythematous placard, and/or swelling or induration at 6 months, cumulating all assessments at each visit (1 week and at 1, 3 and 6 months)., The absence of general infectious complications, defined by the absence of general infectious signs: fever, chills, mottling, hypotension at 6 months, cumulating all assessments at each visit (1 week and at 1, 3 and 6 months)., No increase in anal incontinence compared with the pre-therapeutic evaluation, as assessed by the Wexner index at 6 months, cumulating all assessments at each visit (1 week and at 1, 3 and 6 months)., The absence of any other adverse events considered potentially related to the experimental treatment at 6 months, cumulating all assessments at each visit (1 week and at 1, 3 and 6 months).
Endpoint(s): Remission induced by cryopreserved FVS injection is assessed at 6 months and defined by closure of the external os and absence of collection > 2cm on MRI (= combined remission)., Remission induced by injection of a second dose of FVS is assessed at 6 months and defined by closure of the external os and absence of collection > 2cm on MRI (= combined remission).., Tolerability of a second dose of FVS is defined by evaluation of the overall tolerance profile (see primary endpoint). It is assessed at 6 months as for the primary endpoint., Complete clinical response is assessed at 1 week, 1, 3 and 6 months, and defined by the cessation of suppurations., Partial clinical response is assessed at 1 week, 1, 3 and 6 months and defined by significant reduction in suppuration (reduction ≥ 2 points on the 5-point suppuration scale)., Quality of life is assessed at 1, 3 and 6 months using the Short Inflammatory Bowel Disease Questionnaire (SIBDQ)., Severity of perineal damage is assessed at 1 week and at 1, 3 and 6 months using the Perineal Disease Activity Index (PDAI)., Patients' disease activity is assessed at 1, 3 and 6 months by the Crohn's Disease Activity Index (CDAI), and at 6 months by fecal calprotectin., Closure of the external ostium is assessed at 1 week and at 1, 3 and 6 months, and defined by healing of the ostium or absence of suppuration despite slight digital compression.

Source: https://euclinicaltrials.eu/ctis-public/view/2024-519740-32-00